EU clinical trial 2024-512310-18-00: Randomised, crossover bioequivalence clinical trial of linagliptin/metformin 2.5 mg/1000 mg film-coated tablets, after a single oral dose administration to healthy volunteers under fed conditions.
Protocol code: UECHUP-LIN-MET/24-1
Sponsor: Laboratorios Alter S.A. (Pharmaceutical company). Phase: Human Pharmacology (Phase I)- Bioequivalence Study. Countries: Spain (ended).
Therapeutic area(s): Diseases [C] - Nutritional and Metabolic Diseases [C18]
Gender: Female, Male. Age: 18-64 years. Enrolment: 36.
Status: Ended. Start date (EU): 2024-07-08. End date (EU): 2024-09-16. Decision date: 2024-06-05. Results received: No. Last updated: 2024-06-05.

Condition(s): diabetes

Source: https://euclinicaltrials.eu/ctis-public/view/2024-512310-18-00